EU clinical trial 2024-519654-37-00: A Multicenter, Randomized, Double-blind, Phase 2/3 Study of Ficerafusp Alfa (BCA101) or Placebo in Combination with Pembrolizumab for First-Line Treatment of PD-L1-positive, Recurrent or Metastatic Head and Neck Squamous Cell Carcinoma.
Protocol code: BCA101X301
Sponsor: Bicara Therapeutics Inc. (Pharmaceutical company). Phase: Phase II and Phase III (Integrated). Countries: Belgium (ongoing, recruiting), Austria (ongoing, recruiting), Italy (ongoing, recruiting), Poland (ongoing, recruiting), Spain (ongoing, recruiting), Germany (ongoing, recruiting), Czechia (authorised, recruiting), Ireland (ongoing, recruiting), Greece (ongoing, recruiting), France (ongoing, recruiting), Portugal (ongoing, recruiting).
Therapeutic area(s): Diseases [C] - Neoplasms [C04]
Gender: Female, Male. Age: 18-64 years, 65+ years. Enrolment: 216.
Start date (EU): 2025-11-07. Decision date: 2025-10-06. Results received: No. Last updated: 2026-06-25.
Decision dates by country: IE: 2025-10-10, BE: 2025-10-06, CZ: 2025-10-08, DE: 2025-10-09, AT: 2025-10-13, FR: 2025-10-13, IT: 2025-10-09, PT: 2025-10-06, GR: 2025-10-08, PL: 2025-10-10, ES: 2025-11-03

Condition(s): Recurrent or Metastatic Head and Neck Squamous Cell Carcinoma.
Product: KEYTRUDA 25 mg/mL concentrate for solution for infusion, KEYTRUDA 25 mg/mL concentrate for solution for infusion, KEYTRUDA 25 mg/mL concentrate for solution for infusion, Ficerafusp Alfa, KEYTRUDA 25 mg/mL concentrate for solution for infusion, KEYTRUDA 25 mg/mL concentrate for solution for infusion, KEYTRUDA 25 mg/mL concentrate for solution for infusion, KEYTRUDA 25 mg/mL concentrate for solution for infusion, Saline bag, KEYTRUDA 25 mg/mL concentrate for solution for infusion, Ficerafusp Alfa, PEMBROLIZUMAB

Primary endpoint: Phase 2 (Dose Selection) - Safety: Incidence and severity of TEAEs, treatment-emergent SAEs., Phase 2 (Dose Selection) - Tolerability: TEAEs leading to dose interruption, dose reduction or permanent discontinuation., Phase 2 (Dose Selection) - ORR is defined as the proportion of subjects in the DDS who have a confirmed CR or PR per RECIST 1.1. by BICR, at least 12 weeks of follow-up., Phase 3 - OS: Defined as the time from the randomization to death due to any cause., Phase 3 - ORR: Defined as the proportion of the subjects in the FAS who have confirmed CR or PR by BICR per RECIST 1.1. (Subset of FAS).
Endpoint(s): Phase 2 - DOR: For subjects who demonstrated CR or PR, DOR is defined as the time from first documented evidence of CR or PR until disease progression or death, whichever occurs first, per RECIST 1.1 by BICR., Phase 3 - Safety: Incidence and severity of TEAEs, and treatment-emergent SAEs., Phase 3 - Tolerability: TEAEs leading to dose interruption, dose reduction, or permanent discontinuation., Phase 3 - PFS: Defined as the time from randomization to the first documented PD per RECIST 1.1 as determined by BICR or death due to any cause, whichever occurs first., Phase 3 - ORR: Defined as confirmed CR + PR per RECIST 1.1 by BICR. (FAS)., Phase 3 - DOR: For subjects who demonstrated CR or PR, DOR is defined as the time from first documented evidence of CR or PR until disease progression or death, whichever occurs first per RECIST 1.1 by BICR., Phase 3 - Clinical Benefit Rate: For subject who demonstrated CR + PR + SD>6 months per RECIST 1.1 by BICR. (FAS)., Phase 3 - ORR, DOR, and PFS per RECIST 1.1 as determined by investigator’s assessment., Phase 3 - The TTD in global health status measured by the EORTC QLQ C30 items for global health status and quality of life scale (item 29/30) and pain measured by the EORTC HN 35 (items 31-34) pain domain.

Source: https://euclinicaltrials.eu/ctis-public/view/2024-519654-37-00